EU clinical trial 2022-500657-17-00: A Pragmatic Randomized Trial to Evaluate the Effectiveness of High-Dose Quadrivalent Influenza Vaccine vs. Standard-Dose Quadrivalent Influenza Vaccine in Older Adults
Protocol code: DANFLU-2
Sponsor: Gentofte Hospital, Sanofi Pasteur (Hospital/Clinic/Other health care facility, Pharmaceutical company). Phase: Therapeutic use (Phase IV). Countries: Denmark (ended).
Therapeutic area(s): Diseases [C] - Virus Diseases [C02]
Gender: Female, Male. Age: 65+ years. Enrolment: 339700.
Status: Ended. Start date (EU): 2022-09-10. End date (EU): 2025-08-31. Decision date: 2022-06-28. Results received: No. Last updated: 2024-09-27.
Decision dates by country: DK: 2022-09-06

Condition(s): Prevention of influenza infection in older adults
Product: COVID-19, RNA-BASED VACCINE, Efluelda, injektionsvæske, suspension i fyldt injektionssprøjte, Vaxigriptetra, injektionsvæske, suspension i fyldt injektionssprøjte, Influvactetra, injektionsvæske, suspension i fyldt injektionssprøjte

Primary endpoint: Hospitalization due to influenza or pneumonia [composite endpoint]
Endpoint(s): 1) Hospitalization for any cardio-respiratory disease [composite endpoint], 2) All-cause hospitalization, 3) All-cause mortality, 4) Hospitalization for influenza, 5) Hospitalization for pneumonia

Source: https://euclinicaltrials.eu/ctis-public/view/2022-500657-17-00